EU clinical trial 2024-516386-36-00: A Modular Phase II, Open-Label, Multicentre Study to Assess the Efficacy and Safety of Capivasertib in Patients with Relapsed or Refractory B-cell Non-Hodgkin Lymphoma (CAPITAL)
Protocol code: D361FC00001
Sponsor: AstraZeneca AB (Pharmaceutical company). Phase: Therapeutic exploratory (Phase II). Countries: Spain (ended).
Therapeutic area(s): Diseases [C] - Neoplasms [C04]
Gender: Female, Male. Age: 18-64 years, 65+ years. Enrolment: 1.
Status: Ended. Start date (EU): 2022-03-04. End date (EU): 2024-10-25. End date: 2024-10-26. Decision date: 2024-07-26. Results received: Yes. Last updated: 2024-07-26.

Condition(s): Relapsed or Refractory B-cell Non-Hodgkin Lymphoma
Product: TRUQAP 200 mg film-coated tablets, TRUQAP 160 mg film-coated tablets

Primary endpoint: Objective response rate is defined as the proportion of patients achieving either complete response or partial response according to the Lugano 2014 Classification for NHL as assessed by blinded independent central review (BICR)
Endpoint(s): 1. Duration of response is defined as the time from the date of first documented response until date of documented progression according to the Lugano 2014 Classification for NHL as assessed by BICR, or death due to any cause, 2. Progression-free survival is defined as the time from the date of first dose until documented disease progression according to the Lugano 2014 Classification for NHL as assessed by BICR, or death due to any cause, 3. Overall survival is defined as time from the date of first dose until the date of death due to any cause., 4. Patient-reported disease-related symptoms, functioning and health related quality of life as measured by European Organization for Research and Treatment of Cancer Quality of Life Questionnaire Core 30 (EORTC QLQ-C30), 5. Patient-reported symptomatic AEs and overall side effect burden as measured by PGI-TT and selected items from PRO CTCAE., 6. Time to first subsequent therapy or death (TFST) is defined as time from date of first dose until the start date of first subsequent anti-lymphoma therapy after discontinuation of study treatment or death due to any cause, 7. Time to objective response (TTR) is defined as time from date of first dose until the date of first documented objective response per the Lugano 2014 Classification for NHL as assessed by BICR, 8. Safety and tolerability will be evaluated in terms of AEs, vital signs, clinical laboratory and ECGs, 9. Plasma concentration of capivasertib pre-dose and post-dose

Source: https://euclinicaltrials.eu/ctis-public/view/2024-516386-36-00